EU clinical trial 2026-526153-34-00: 150 mg CIT-013 phase 1 trial
Protocol code: CITRYLL006 - Citysky
Sponsor: Citryll B.V. (Pharmaceutical company). Phase: Human Pharmacology (Phase I)- Other. Countries: Netherlands (authorised, recruiting).
Therapeutic area(s): Diseases [C] - Immune System Diseases [C20]
Gender: Female, Male. Age: 18-64 years, 65+ years. Enrolment: 10.
Status: Authorised, recruiting. Start date (EU): 2026-05-26. Decision date: 2026-05-22. Results received: No. Last updated: 2026-05-22.

Condition(s): Immune mediated inflammatory diseases

Source: https://euclinicaltrials.eu/ctis-public/view/2026-526153-34-00